EU clinical trial 2025-523928-52-00: PaTHway Adolescent - A Phase 3, Multicenter, Open-Label Single-Arm Clinical Trial to Assess the Safety, Tolerability, Pharmacokinetics, and Efficacy of Palopegteriparatide Administered Subcutaneously Daily in the Adolescent Population (12 Years to Less Than 18 Years of Age) with Chronic Hypoparathyroidism
Protocol code: ASND0035
Sponsor: Ascendis Pharma Bone Diseases A/S (Pharmaceutical company). Phase: Therapeutic confirmatory (Phase III). Countries: Germany (authorised, recruitment pending), France (ongoing, recruiting), Romania (authorised, recruitment pending), Poland (ongoing, recruiting).
Therapeutic area(s): Diseases [C] - Hormonal diseases [C19]
Gender: Female, Male. Age: 0-17 years. Enrolment: 11.
Start date (EU): 2026-04-22. Decision date: 2026-03-09. Results received: No. Last updated: 2026-05-13.
Decision dates by country: FR: 2026-03-10, DE: 2026-03-09, RO: 2026-03-23, PL: 2026-03-23

Condition(s): Chronic hypoparathyroidism
Product: Yorvipath 420 micrograms/1.4 mL solution for injection in pre‑filled pen, Yorvipath 168 micrograms/0.56 mL solution for injection in pre-filled pen, Yorvipath 294 micrograms/0.98 mL solution for injection in pre‑filled pen

Primary endpoint: At Week 26, proportion of participants with: Albumin-adjusted serum calcium within the normal range measured within 4 weeks prior to and on the Week 26 visit; and, Independence from active vitamin D and, Independence from therapeutic doses of calcium. Calcium ≤600 mg/day (in the form of tablets, powder, liquid suspension, or transdermal patch) is considered as “supplemental” to meet recommended daily intake for general health, as opposed to a “therapeutic” dose to treat hypoparathyroidism

Source: https://euclinicaltrials.eu/ctis-public/view/2025-523928-52-00